EU clinical trial 2023-506525-11-00: A Phase III, Randomized, Open-Label Active Comparator-Controlled Multicenter Study to Evaluate Efficacy and Safety of Obinutuzumab in Patients with Primary Membranous Nephropathy
Protocol code: WA41937
Sponsor: F. Hoffmann-La Roche AG (Pharmaceutical company). Phase: Therapeutic confirmatory (Phase III). Countries: Poland (ongoing, recruitment ended), Italy (ongoing, recruitment ended), France (ongoing, recruitment ended), Spain (ongoing, recruitment ended).
Therapeutic area(s): Diseases [C] - Immune System Diseases [C20]
Gender: Female, Male. Age: 18-64 years, 65+ years. Enrolment: 52.
Status: Ongoing, recruitment ended. Start date (EU): 2021-04-19. Decision date: 2024-03-05. Results received: No. Last updated: 2026-05-26.
Decision dates by country: FR: 2024-03-05, ES: 2024-03-05, PL: 2024-03-07, IT: 2024-04-02

Condition(s): Primary Membranous Nephropathy (pMN)
Product: Prograf 5 mg Hartkapseln, Gazyvaro 1,000 mg concentrate for solution for infusion., Prograf 0,5 mg Hartkapseln, Prograf 1 mg Hartkapseln

Primary endpoint: 1. The proportion of patients who achieve a CR at Week 104
Endpoint(s): 1. The proportion of patients who achieve an overall remission at Week 104, 2. The proportion of patients who achieve CR at Week 76, 3. Time to treatment failure, meeting escape criteria, or relapse after complete or partial remission, 4. Time to a sustained reduction of eGFR >= 30% from baseline, 5. Mean change in T-score from baseline in the Patient-Reported Outcomes Measurement Information System (PROMIS) Fatigue scale at Week 104, 6. Duration of CR, 7. Change in anti-PLA2R autoantibody titer from Baseline to Week 52, 8. Mean change from baseline in the Patient-Reported Outcomes Measurement Information System (PROMIS) Global Assessment of Physical Health scale at Week 104, 9. Incidence and severity of adverse events, with severity determined according to National Cancer Institute Common Terminology Criteria for Adverse Events version 5.0, 10. Characterization of adverse events of special interest, 11. Change from baseline in targeted vital signs, 12. Change from baseline in targeted clinical laboratory test results, 13. Serum concentrations of obinutuzumab at specified timepoints, 14. Peripheral B-cell counts at specified timepoints, 15. Prevalence of anti-drug antibodies (ADAs) to obinutuzumab at baseline and incidence of ADAs during the study

Source: https://euclinicaltrials.eu/ctis-public/view/2023-506525-11-00